EU clinical trial 2023-508095-11-00: A multicenter, open-label, single-arm study to evaluate long-term safety and tolerability of brivaracetam in study participants with childhood absence epilepsy or juvenile absence epilepsy
Protocol code: EP0224
Sponsor: UCB Biopharma (Pharmaceutical company). Phase: Therapeutic confirmatory (Phase III). Countries: Italy (ended), Romania (ended), Spain (ended), Slovakia (ongoing, recruitment ended).
Therapeutic area(s): Diseases [C] - Nervous System Diseases [C10]
Gender: Female, Male. Age: 0-17 years, 18-64 years. Enrolment: 31.
Start date (EU): 2024-11-27. Decision date: 2024-07-19. Results received: No. Last updated: 2026-03-04.
Decision dates by country: SK: 2024-07-19, ES: 2024-07-23, RO: 2024-07-24, IT: 2024-07-24

Condition(s): Childhood Absence Epilepsy, Juvenile Absence Epilepsy
Product: brivaracetam, brivaracetam, brivaracetam, brivaracetam

Primary endpoint: - Incidence of treatment-emergent adverse events (TEAEs) during the study - Incidence of treatment-emergent adverse events (TEAEs) leading to discontinuation of investigational medicinal product (IMP) during the study
Endpoint(s): - Incidence of serious adverse events (SAEs) during the study - Incidence of IMP related TEAEs during the study

Source: https://euclinicaltrials.eu/ctis-public/view/2023-508095-11-00